EU clinical trial 2023-504598-18-00: A Phase 1 first-in-human study evaluating safety, pharmacokinetics and efficacy of ABBV-706 as monotherapy and in combination with budigalimab (ABBV-181), carboplatin, or cisplatin in adult subjects with advanced solid tumors.
Protocol code: M23-385
Sponsor: AbbVie Deutschland GmbH & Co. KG (Pharmaceutical company). Phase: Human Pharmacology (Phase I)- First administration to humans. Countries: France (ended), Italy (ended), Spain (ongoing, recruitment ended), Germany (ended).
Therapeutic area(s): Diseases [C] - Neoplasms [C04]
Gender: Female, Male. Age: 18-64 years, 65+ years. Enrolment: 120.
Start date (EU): 2024-04-03. Decision date: 2024-02-06. Results received: No. Last updated: 2026-06-11.
Decision dates by country: FR: 2024-02-12, IT: 2024-02-06, ES: 2024-02-06, DE: 2024-02-09

Condition(s): Advanced solid tumors

Source: https://euclinicaltrials.eu/ctis-public/view/2023-504598-18-00